EU clinical trial 2025-523328-31-00: A study on the safety, tolerability, and effectiveness of the new drug LAD106 in healthy volunteers.
Protocol code: M-27312-01
Sponsor: Almirall S.A. (Pharmaceutical company). Phase: Human Pharmacology (Phase I)- First administration to humans. Countries: Netherlands (ongoing, recruiting).
Therapeutic area(s): Diseases [C] - Immune System Diseases [C20]
Gender: Female, Male. Age: 18-64 years. Enrolment: 93.
Status: Ongoing, recruiting. Start date (EU): 2026-02-06. Decision date: 2026-02-06. Results received: No. Last updated: 2026-07-10.

Condition(s): Inflammatory diseases

Source: https://euclinicaltrials.eu/ctis-public/view/2025-523328-31-00